EU clinical trial 2025-521785-10-00: A Global, Multicenter, Prospective, Controlled, Open-Label Pivotal Study of Iodofalan (131I) Solution for Injection (TLX101-Tx) Plus Lomustine Versus Lomustine Alone in Patients with Radiographically Confirmed Recurrent Glioblastoma at First Recurrence (IPAX-3)
Protocol code: 131I-TLX-101-003
Sponsor: Telix Pharmaceuticals (Innovations) Pty Limited (Pharmaceutical company). Phase: Therapeutic confirmatory (Phase III). Countries: Austria (ongoing, recruiting), Netherlands (ongoing, recruiting), Belgium (authorised, recruiting), Denmark (authorised, recruitment pending), France (authorised, recruitment pending), Spain (authorised, recruitment pending).
Therapeutic area(s): Diseases [C] - Neoplasms [C04]
Gender: Female, Male. Age: 18-64 years, 65+ years. Enrolment: 55.
Start date (EU): 2026-03-04. Decision date: 2025-10-13. Results received: No. Last updated: 2026-07-06.
Decision dates by country: NL: 2025-11-21, AT: 2025-11-19, DK: 2026-06-15, FR: 2026-07-06, ES: 2026-06-30, BE: 2026-01-21

Condition(s): Glioblastoma
Product: 4-L-[131I]iodo-phenylalanine, LOMUSTINE, LOMUSTINE

Primary endpoint: Part 1 Safety and Dosimetry Lead-in: Part 1a BOIN: Assessment of TEAEs type as described as dose-limiting, frequency, severity according to NCI CTCAE v5.0., Part 1 Safety and Dosimetry Lead-in: Part 1b Dose Expansion Cohort: Safety assessments include physical examination, vital signs, ECG abnormalities, clinical laboratory assessments, adverse events reported according to the NCI CTCAE v5.0. Tolerability as assessed by HRQoL total scores on European Organization for Research and Treatment of Cancer – EORTC QLQ-C30 and EORTC-BN20 questionnaires, neurological symptoms assessed with the NANO scale., Part 2 Randomized Study: OS determined from the date of enrollment until death from any cause.
Endpoint(s): Part 1 Safety and Dosimetry Lead-In: Part 1a and 1b:Absorbed radiation doses based on quantitative imaging (expressed as mGy/MBq of administered TLX101-Tx) to tumor and bone marrow, using SPECT imaging. The planar images of the head and tumor volume estimates from CT/MRI will be used to obtain an estimate of the tumor dose per administered activity of 131I., Part 1a and 1b: Time course of the radioactivity and of TLX101 in blood and cumulative urine excretion of the radioactivity after administration of TLX101-Tx Blood and urine PK parameters of TLX101-Tx, PK/PD modeling will be performed using venous blood samples and if data allows, exposure-response analyses will be performed to correlate blood PK metrics and/or tumor and organ absorbed doses to efficacy and safety endpoints., Part 1a BOIN: Safety assessments include physical examination, vital signs, ECG abnormalities, clinical laboratory assessments, adverse events reported according to the NCI CTCAE v5.0. Tolerability as assessed by HRQoL total scores on European Organization for Research and Treatment of Cancer – EORTC QLQ-C30 and EORTC-BN20 questionnaires, neurological symptoms assessed with the NANO scale., Part 1b Dose Expansion Cohort: PFS from the time of enrollment as assessed by central core lab using RANO 2.0 or death due to any cause (whichever occurs first)., Part 1b Dose Expansion Cohort: Objective response rate assessed by the central core lab according to RANO 2.0., Part 2 Randomized Study: PFS from the date of enrollment randomization per RANO 2.0 criteria as assessed by the central core lab or death due to any cause (whichever occurs first)., Part 2 Randomized Study: Tolerability as assessed by HRQoL total scores on European Organization for Research and Treatment of Cancer – EORTC QLQ-C30 and EORTC-BN20 questionnaires., Part 2 Randomized Study: Safety assessments include physical examination, vital signs, and clinical laboratory assessments as well as adverse events reported according to the NCI CTCAE v5.0.

Source: https://euclinicaltrials.eu/ctis-public/view/2025-521785-10-00